EU clinical trial 2024-517479-19-00: Phase II study evaluating the efficacy of Nivolumab in the treatment of patients with nasopharyngeal cancer who progressed during or after platinum-based chemotherapy
Protocol code: 20-NIO-0003
Sponsor: Narodowy Instytut Onkologii Im. Marii Sklodowskiej-Curie Panstwowy Instytut Badawczy (Hospital/Clinic/Other health care facility). Phase: Therapeutic exploratory (Phase II). Countries: Poland (ongoing, recruiting).
Therapeutic area(s): Diseases [C] - Neoplasms [C04]
Gender: Female, Male. Age: 18-64 years, 65+ years. Enrolment: 32.
Status: Ongoing, recruiting. Start date (EU): 2021-08-26. Decision date: 2024-11-18. Results received: No. Last updated: 2025-11-04.

Condition(s): Nasopharyngeal Cancer
Product: OPDIVO 10 mg/mL concentrate for solution for infusion., OPDIVO 10 mg/mL concentrate for solution for infusion., OPDIVO 10 mg/mL concentrate for solution for infusion.

Primary endpoint: Objective response rate (ORR), defined as percentage of objective responses (partial and complete responses combined /PR + CR/ by iRECIST response criteria) in MRI after 12 weeks. a. Partial response (PR)- at least a 30% decrease in the sum of the LD of target lesions, taking as reference the baseline sum LD b. Complete response (CR)- disappearance of all target lesions and short dimension of all lymph nodes < 10 mm
Endpoint(s): Progression- free survival (PFS) by iRECIST criteria- from the beginning of treatment to the progression of disease or death. Progression will be evaluated in MRI (after 6 months of treatment phase) and defined according to iRECIST criteria., Overall survival (OS) rate- time of total survival – at 6 months (treatment phase), 12 months and 18 months (6th month and 12th month of long term follow up), DCR per RECIST (disease control rate)- defined as not meeting the criteria for progression and PR; measured in MRI from the start of the treatment until the criteria for disease progression is met., DoR per RECIST (duration of response) – measured in MRI from the time when measurement criteria for complete/ partial response are met till time when progression of the disease is documented., Change in quality of life in EORTC QLQ-C30 (version 3.0) from baseline to last infusion., Change in quality of life in EORTC QLQ-C30 (version 3.0) - from baseline to last follow up., Safety assessment of treatment with Nivolumab : • total rate of patient, who discontinues from infusion due to excesive toxicity, measured after end of treatment phase • time from start of treatment to occurrence of excesive toxicity preventing from continuation the infusion of Nivolumab, assessed at each visit during treatment phase.

Source: https://euclinicaltrials.eu/ctis-public/view/2024-517479-19-00